EU clinical trial 2024-518464-12-00: POPular GUILTY PILOT: Genotype-guided Clopidogrel monotherapy
Sponsor: Sint Antonius Ziekenhuis Stichting (Hospital/Clinic/Other health care facility). Phase: Therapeutic use (Phase IV). Countries: Netherlands (ongoing, recruiting).
Therapeutic area(s): Diseases [C] - Cardiovascular Diseases [C14]
Gender: Female, Male. Age: 18-64 years, 65+ years. Enrolment: 200.
Status: Ongoing, recruiting. Start date (EU): 2024-10-15. Decision date: 2024-10-15. Results received: No. Last updated: 2026-01-29.
Decision dates by country: NL: 2024-11-26

Condition(s): Non-ST-segment Elevation Acute Coronary Syndrome, Coronary Artery Disease
Product: Clopidogrel 75 mg film-coated tablets, Acetylsalicylzuur Cardio Teva 80 mg

Primary endpoint: The primary ischemic endpoints at 6 months is the composite of all-cause mortality, myocardial infarction, definite or probable stent thrombosis, and ischemic stroke, The primary bleeding endpoint at 6 months is major or minor bleeding (BARC type 2, 3 or 5 bleeding)
Endpoint(s): Primary ischemic and bleeding endpoint at 1 month, Each individual component of the primary endpoints at 1 and 6 months, Cardiovascular mortality at 1 and 6 months., Non-cardiovascular mortality at 1 and 6 months., Any need for revascularization at 1 and 6 months., Any periprocedural complications.

Source: https://euclinicaltrials.eu/ctis-public/view/2024-518464-12-00